EU clinical trial 2024-519369-24-00: C2321008: A PHASE 3, RANDOMIZED, DOUBLE BLIND, PLACEBO-CONTROLLED STUDY OF MEVROMETOSTAT (PF-06821497) WITH ENZALUTAMIDE IN METASTATIC CASTRATION-SENSITIVE PROSTATE CANCER (MEVPRO-3)
Protocol code: C2321008
Sponsor: Pfizer Inc. (Pharmaceutical company). Phase: Therapeutic confirmatory (Phase III). Countries: Belgium (ongoing, recruiting), Finland (ongoing, recruiting), France (ongoing, recruiting), Germany (ongoing, recruiting), Netherlands (ongoing, recruiting), Bulgaria (ongoing, recruiting), Spain (ongoing, recruiting), Slovakia (ongoing, recruiting), Italy (ongoing, recruiting), Czechia (ongoing, recruiting), Poland (ongoing, recruiting), Greece (ongoing, recruiting).
Therapeutic area(s): Not possible to specify
Gender: Male. Age: 18-64 years, 65+ years. Enrolment: 434.
Status: Ongoing, recruiting. Start date (EU): 2026-01-29. Decision date: 2025-12-22. Results received: No. Last updated: 2026-05-27.
Decision dates by country: BE: 2026-01-12, FR: 2026-01-09, DE: 2025-12-23, ES: 2026-01-02, NL: 2025-12-30, PL: 2026-01-04, SK: 2025-12-22, BG: 2026-01-07, GR: 2025-12-24, IT: 2026-02-27, CZ: 2026-01-08, FI: 2025-12-22

Condition(s): METASTATIC CASTRATION-SENSITIVE PROSTATE CANCER
Product: Xtandi - 40 mg soft capsules, PF-06821497, PF-06821497, Tablet to match placebo for pf-06821497 125mg, Tablet to match placebo for pf-06821497 250mg

Primary endpoint: BICR assessed rPFS per RECIST 1.1 (soft tissue disease) and PCWG3 (bone disease)
Endpoint(s): OS (alpha protected), Proportion of participants with measurable soft tissue disease at baseline with an objective response per RECIST 1.1 (assessed by BICR and investigator), Duration of soft tissue response per RECIST 1.1 (assessed by BICR and investigator), Proportion of participants with prostate-specific antigen (PSA) response ≥50% in participants with detectable PSA values at baseline, Time to PSA progression, Time to initiation of antineoplastic therapy, Time to first symptomatic skeletal event, Time from randomization to castration-resistant prostate cancer (CRPC), Type, incidence, severity (as graded by the National Cancer Institute [NCI] Common Terminology Criteria for Adverse Events [CTCAE] v5.0), seriousness and relationship to study medications of adverse events (AEs) and any laboratory test and electrocardiogram (ECG) abnormalities, PK characterized by pre-dose trough and post-dose plasma concentrations of mevrometostat at selected visits, Change from baseline and time to confirmed deterioration in participantreported worst pain symptoms per Brief Pain Inventory – Short Form (BPI-SF), Change from baseline in health-related quality of life (HRQoL), functioning, and symptoms and time to definitive deterioration per Functional Assessment of Cancer Therapy – Prostate (FACT-P), Change from baseline and time to definitive deterioration in participantreported prostate cancer specific functioning and symptoms per European Organization for Research and Treatment of Cancer Quality of Life Questionnaire-Prostate Cancer 25 (EORTC QLQ-PR25), Change from baseline and time to confirmed deterioration in participantreported fatigue symptoms per Brief Fatigue Inventory (BFI), Change from baseline in participant-reported general health status per European Quality of Life 5-Dimensions 5-Level (EQ-5D-5L), ctDNA burden at baseline and on study

Source: https://euclinicaltrials.eu/ctis-public/view/2024-519369-24-00